EU clinical trial 2023-503573-38-00: Safety of stem cells in treatmemt of retinal diseases.
Protocol code: RD-opMSCs-01
Sponsor: Bioinova a.s. (Pharmaceutical company). Phase: Human Pharmacology (Phase I)- Other. Countries: Czechia (authorised, recruitment pending).
Therapeutic area(s): Diseases [C] - Eye Diseases [C11]
Gender: Female, Male. Age: 18-64 years. Enrolment: 10.
Status: Authorised, recruitment pending. Decision date: 2026-04-28. Results received: No. Last updated: 2026-04-28.

Condition(s): Retinal degenerative diseases

Source: https://euclinicaltrials.eu/ctis-public/view/2023-503573-38-00